EU clinical trial 2023-509761-21-00: CARE : Impact of Regorafenib in combination with multimodal metronomic chemotherapy (cyclophosphamide, capecitabine, and low-dose aspirin) on progression-free survival compared with standard Regorafenib for the treatment of chemo-resistant metastatic colorectal cancers
Protocol code: 2023/805
Sponsor: Centre Hospitalier Regional Universitaire (Hospital/Clinic/Other health care facility). Phase: Therapeutic confirmatory (Phase III). Countries: France (ongoing, recruiting).
Therapeutic area(s): Diseases [C] - Digestive System Diseases [C06]
Gender: Female, Male. Age: 18-64 years, 65+ years. Enrolment: 174.
Status: Ongoing, recruiting. Start date (EU): 2024-07-08. Decision date: 2024-03-25. Results received: No. Last updated: 2026-07-08.

Condition(s): Metastatic colorectal cancer
Product: Xeloda 500 mg film-coated tablets, Stivarga 40 mg film-coated tablets, KARDEGIC 75 mg, poudre pour solution buvable en sachet-dose, ENDOXAN 50 mg, comprimé enrobé, Xeloda 150 mg film-coated tablets

Primary endpoint: Progression-free survival (PFS): defined as the time from the randomization date to disease progression as per RECIST v1.1 or death from any cause, whichever occurs first. Alive patients without progression will be censored at last radiological evaluation available in the study arms treatment setting showing no progression.
Endpoint(s): Health related Quality of life : - EORTC QLC30 + CR29, EQ-5D-5L questionnaires - 5 prespecified targeted dimensions of interest : Global health/ Pain/ Physical Functioning / Fatigue / Emotional Functioning - Number of days of hospitalization, Toxicities graded according to NCI-CTCAE criteria version, Overall survival (OS): defined as the time from the randomization date to death from any cause. Alive patients will be censored at the last date known to be alive, either during study treatment period or during follow-up period., Disease control rate (DCR): DCR is defined as the proportion of participants with best overall response of confirmed CR or PR or stable disease (SD)., Duration of objective response (DOR): defined as the time from the first documented objective response of PR or CR, whichever is noted earlier, to disease progression or death (if death occurs before progression is documented). DOR will be defined for responders only, i.e. patients with a CR or PR. The actual dates the tumor scans were performed will be used for this calculation. DOR for patients who have not progressed or died at the time of analysis will be censored at the date of last TM, Evaluation of CHUN morphological criteria, Economic evaluation: incremental cost-utility ratio: EuroQol-5D-5L (EQ-5D-5L) questionnaire and VAS (repeated measures at baseline, W8, M4, M6, M8, M10, M12 and end of study M18)

Source: https://euclinicaltrials.eu/ctis-public/view/2023-509761-21-00